EU clinical trial 2023-509136-25-00: Adjuvant immunotherapy with anti-PD-1 monoclonal antibody Pembrolizumab (MK-3475) versus placebo after complete resection of high-risk Stage III melanoma: A randomized, double- blind Phase 3 trial of the EORTC Melanoma Group
Protocol code: MK3475-054
Sponsor: Merck Sharp & Dohme LLC (Pharmaceutical company). Phase: Therapeutic confirmatory (Phase III). Countries: Portugal (ongoing, recruitment ended), Sweden (ongoing, recruitment ended), Poland (ongoing, recruitment ended), Finland (ongoing, recruitment ended), Netherlands (ongoing, recruitment ended), Spain (ongoing, recruitment ended), Italy (ongoing, recruitment ended), France (ongoing, recruitment ended), Austria (ongoing, recruitment ended), Germany (ongoing, recruitment ended), Belgium (ongoing, recruitment ended), Norway (ongoing, recruitment ended), Denmark (ongoing, recruitment ended).
Therapeutic area(s): Diseases [C] - Neoplasms [C04]
Gender: Female, Male. Age: 18-64 years, 65+ years. Enrolment: 572.
Status: Ongoing, recruitment ended. Start date (EU): 2015-07-16. Decision date: 2024-07-09. Results received: No. Last updated: 2026-07-16.
Decision dates by country: NO: 2024-07-09, BE: 2024-07-09, AT: 2024-07-15, FI: 2024-07-09, ES: 2024-07-10, DK: 2024-07-10, SE: 2024-07-09, NL: 2024-07-10, PL: 2024-07-15, PT: 2024-07-09, IT: 2024-07-15, DE: 2024-07-11, FR: 2024-07-15

Condition(s): Stage III melanoma (AJCC R0) with histologically confirmed cutaneous melanoma metastatic to lymph node, classified as (AJCC, 2010): Stage IIIA with metastasis > 1 mm; any Stage IIIB or IIIC (no in-transit metastases)
Product: Saline Solution, KEYTRUDA 25 mg/mL concentrate for solution for infusion

Primary endpoint: ♦ Recurrence-free survival (RFS), ♦ RFS for patients with PD-L1-positive expression
Endpoint(s): ♦ Distant metastases-free survival (DMFS), ♦ DMFS for patients with PD-L1-positive expression, ♦ Overall survival (OS), ♦ OS for patients with PD-L1-positive expression, ♦ Pharmacokinetics (PK) of pembrolizumab

Source: https://euclinicaltrials.eu/ctis-public/view/2023-509136-25-00